EU clinical trial 2023-507089-18-00: OBEVIDOS “Treatment of vitamin D deficit in obese children and adolescents: an open label randomized controlled study comparing the efficacy of two oral supplementation regimens: monthly boluses versus daily doses for correcting blood vitamin D level.”
Protocol code: 69HCL18_0148
Sponsor: Hospices Civils De Lyon (Hospital/Clinic/Other health care facility). Phase: Therapeutic confirmatory (Phase III). Countries: France (ongoing, recruiting).
Therapeutic area(s): Diseases [C] - Nutritional and Metabolic Diseases [C18]
Gender: Female, Male. Age: 0-17 years. Enrolment: 68.
Status: Ongoing, recruiting. Start date (EU): 2023-11-24. Decision date: 2023-09-20. Results received: No. Last updated: 2026-05-07.

Condition(s): Obese children and adolescents
Product: ZYMAD 50 000 UI, solution buvable en ampoule, ZYMAD 10 000 UI/ml, solution buvable en gouttes

Primary endpoint: Vitamin D (25(OH)D) serum level in each treatment arm (monthly bolus or daily supplementation), 3 months after the initiation of the treatment
Endpoint(s): For blood samples at M0 and M3: vitamin D (25OHD serum level), calcium, phosphore. For urinary samples at M0 and M3: calcium, phosphore and urinary calcium/creatinine;, Amount of treatment taken compared to theoretical treatment quantity (Daily arm: patient diary and weighting of returned treatment at M3. Bolus arm: description of taken ampoules after hospital dosing (number taken, empty or not)), Type of skin (phototype), physical activity (physical activity questionnaire), sun exposure (sun exposure questionnaire), and alimentary intakes (Fardelonne and vitamin D intake questionnaires) at M0; and vitamin D (25(OH)D) serum level in each treatment arm at M3, Bone mineral density (DXA) for patients ≥ 10 years old at M0 and in comparison with data from healthy control (local VITADOS cohort)., Bone mineral density (DXA) at M0, Change in PTH serum level between M0 and M3

Source: https://euclinicaltrials.eu/ctis-public/view/2023-507089-18-00